EU clinical trial 2024-511482-11-00: ReNEW: A Phase 3, Randomized, Double-Masked, Placebo-Controlled Clinical Trial to Evaluate the Efficacy, Safety, and Pharmacokinetics of Subcutaneous Injections of Elamipretide in Subjects who have Dry Age-Related Macular Degeneration (Dry AMD)
Protocol code: SPIAM-301
Sponsor: Stealth Biotherapeutics Inc. (Pharmaceutical company). Phase: Therapeutic confirmatory (Phase III). Countries: Italy (ongoing, recruitment ended), Hungary (ongoing, recruitment ended), Germany (ongoing, recruitment ended), Czechia (ongoing, recruitment ended), Spain (ongoing, recruitment ended).
Therapeutic area(s): Diseases [C] - Eye Diseases [C11]
Gender: Female, Male. Age: 18-64 years, 65+ years. Enrolment: 95.
Status: Ongoing, recruitment ended. Start date (EU): 2024-11-20. Decision date: 2024-09-20. Results received: No. Last updated: 2026-02-16.
Decision dates by country: IT: 2024-09-23, DE: 2024-09-20, ES: 2024-09-20, HU: 2024-09-30, CZ: 2024-09-23

Condition(s): Dry Age-Related Macular Degeneration (Dry AMD)
Product: Elamipretide, The placebo for this trial will be composed of excipients used to manufacture the investigational drug but without the active drug substance.

Primary endpoint: Rate of change in the macular area of photoreceptor loss (defined as an Ellipsoid Zone – Retinal Pigment Epithelium (EZ-RPE) thickness of 0μm) assessed by spectral domain-optical coherence tomography (SD-OCT) and Ellipsoid Zone (EZ) mapping at Week 48
Endpoint(s): Efficacy: Rate of change in the macular area of photoreceptor loss (defined as an EZ-RPE thickness of 0μm) assessed by SD-OCT and EZ mapping at Week 72, Efficacy: Rate of change in the macular area of photoreceptor loss (defined as an EZ-RPE thickness of 0μm) assessed by SD-OCT and EZ mapping at Week 96, Efficacy: Proportion of subjects gaining ≥ 10 letters (2 lines) in Low Luminance Best-Corrected Visual Acuity (LL BCVA) from baseline at Week 48, Efficacy: Proportion of subjects gaining ≥ 15 letters (3 lines) in LL BCVA from baseline at Week 48

Source: https://euclinicaltrials.eu/ctis-public/view/2024-511482-11-00